EU clinical trial 2024-519481-44-00: A phase II randomized clinical study of the combination of avelumab plus cetuximab as rechallenge strategy in pre-treated RAS/BRAF wild type metastatic colorectal cancer patients
Protocol code: CAVE-2
Sponsor: Gruppo Oncologico Dell'Italia Meridionale (Patient organisation/association). Phase: Therapeutic exploratory (Phase II). Countries: Italy (ongoing, recruiting).
Therapeutic area(s): Diseases [C] - Neoplasms [C04]
Gender: Female, Male. Age: 18-64 years, 65+ years. Enrolment: 173.
Status: Ongoing, recruiting. Start date (EU): 2025-01-08. Decision date: 2025-01-08. Results received: No. Last updated: 2026-01-21.

Condition(s): colorectal metastatic cancer
Product: CETUXIMAB, AVELUMAB

Primary endpoint: The primary endpoint for the trial is OS time, defined as the interval from enrollment to death for every cause
Endpoint(s): The overall response rate (ORR) according to RECIST 1.1 defined as the proportion of patients who have a partial or complete response to therapy, Progression free survival (PFS) according to RECIST 1.1 defined as the time from random assignment in the clinical trial to disease progression or death from any cause., Safety endpoints include AEs, assessed throughout the trial and evaluated using the NCI- CTCAE version 5.0 (CTCAE v 5.0), clinical laboratory assessments, vital signs, and electrocardiogram (ECG) parameters

Source: https://euclinicaltrials.eu/ctis-public/view/2024-519481-44-00